EU clinical trial 2024-518310-28-00: Role of Vitamin C at 6 Months on Incidence of Complex Regional Pain Syndrome Type I in Upper Limb Surgery (CRPS-VITC)
Protocol code: PI2015_843_0001
Sponsor: Centre Hospitalier Universitaire Amiens Picardie (Hospital/Clinic/Other health care facility). Phase: Therapeutic confirmatory (Phase III). Countries: France (authorised, recruitment pending).
Therapeutic area(s): Diseases [C] - Musculoskeletal Diseases [C05]
Gender: Female, Male. Age: 18-64 years, 65+ years. Enrolment: 1000.
Status: Authorised, recruitment pending. Decision date: 2024-10-10. Results received: No. Last updated: 2024-10-10.

Condition(s): Algoneurodystrophy CRPS type 1
Product: CELLULOSE, MICROCRYSTALLINE, L-ASCORBIC ACID

Primary endpoint: Appearance of a complex regional pain syndrome (CRPS) 6 months after surgery
Endpoint(s): Epidemiological description of CRPS affected population, Appearance of a complex regional pain syndrome (CRPS) 12 months after surgery, C Vitamin tolerance and protocol compliance

Source: https://euclinicaltrials.eu/ctis-public/view/2024-518310-28-00